EU clinical trial 2026-525813-30-00: A study in healthy people to measure how different doses of verducatib affect the heart
Protocol code: 1397-0025
Sponsor: Boehringer Ingelheim International GmbH (Pharmaceutical company). Phase: Human Pharmacology (Phase I)- Other. Countries: Germany (authorised, recruitment pending).
Therapeutic area(s): Not possible to specify
Gender: Female, Male. Age: 18-64 years. Enrolment: 56.
Status: Authorised, recruitment pending. Decision date: 2026-07-27. Results received: No. Last updated: 2026-07-27.

Condition(s): Healthy volunteer trial

Source: https://euclinicaltrials.eu/ctis-public/view/2026-525813-30-00